EU clinical trial 2024-518846-25-00: A Phase II, Open Study to Assess Efficacy and Safety of Rigosertib in Patients with Recessive Dystrophic Epidermolysis bullosa associated Locally Advanced/Metastatic Squamous Cell Carcinoma
Sponsor: Eb Haus Austria Gemeinnuetzige Salzburger Landeskliniken Betriebsgesellschaft mbH (Hospital/Clinic/Other health care facility). Phase: Therapeutic exploratory (Phase II). Countries: Austria (ended).
Therapeutic area(s): Diseases [C] - Skin and Connective Tissue Diseases [C17]
Gender: Female, Male. Age: 18-64 years, 65+ years. Enrolment: 12.
Status: Ended. End date (EU): 2025-12-01. Decision date: 2024-12-10. Results received: Yes. Last updated: 2024-12-10.

Condition(s): Recessive Dystrophic Epidermolysis bullosa associated Locally Advanced/Metastatic Squamous Cell Carcinoma
Product: Rigosertib Sodium IV, Rigosertib Sodium Oral

Primary endpoint: To determine the Objective Response Rate (ORR) of therapy with Rigosertib in RDEB patients with locally advanced/metastatic squamous cell carcinoma of the skin using Response Criteria in Solid Tumors Version 1.1 (RECIST1.1) per site assessment up to 52 weeks by CT/MR Scan., To evaluate the safety and tolerability of Rigosertib administered either orally as capsules or dissolved capsules daily for three weeks on, one week off or IV as a 72- hr CIV infusion on days 1, 2, and 3 of a 2-week cycle for the first eight 2-week cycles, then on days 1, 2, and 3 of a 4-week cycle thereafter.
Endpoint(s): Assess impact on quality of life (QOLEB)., Biomarker analysis (to include markers of PI3K/Akt and PLK1 pathways) performed on all archival tissues from all patients.

Source: https://euclinicaltrials.eu/ctis-public/view/2024-518846-25-00